EU clinical trial 2024-516216-16-00: An interventional Phase 3, open-label, two-cohort study to investigate the efficacy and safety of fosmanogepix in adult patients with invasive mold infections caused by Aspergillus spp., Fusarium spp., Lomentospora prolificans, Mucorales fungi, or other multidrug resistant molds
Protocol code: FMGX-CS-302
Sponsor: Basilea Pharmaceutica International AG Allschwil (Pharmaceutical company). Phase: Therapeutic confirmatory (Phase III). Countries: France (ongoing, recruiting), Germany (ongoing, recruiting), Spain (ongoing, recruiting), Netherlands (ongoing, recruiting), Belgium (ongoing, recruiting), Italy (ongoing, recruiting), Austria (ongoing, recruiting), Greece (ongoing, recruiting).
Therapeutic area(s): Diseases [C] - Bacterial Infections and Mycoses [C01]
Gender: Female, Male. Age: 18-64 years, 65+ years. Enrolment: 94.
Status: Ongoing, recruiting. Start date (EU): 2026-02-13. Decision date: 2025-08-05. Results received: No. Last updated: 2026-06-15.
Decision dates by country: DE: 2025-08-06, IT: 2025-08-06, GR: 2025-08-11, AT: 2025-08-11, FR: 2025-08-08, ES: 2025-08-07, BE: 2025-08-08, NL: 2025-08-05

Condition(s): Invasive mold infections caused by Aspergillus spp., Fusarium spp., Lomentospora prolificans, Mucorales fungi, or other multidrug resistant molds
Product: TERBINAFINE, Fosmanogepix, ANIDULAFUNGIN, MICAFUNGIN, CASPOFUNGIN, Fosmanogepix, AMPHOTERICIN B, POSACONAZOLE, VORICONAZOLE, ISAVUCONAZOLE

Primary endpoint: Day 42 all-cause mortality rate. [Time Frame: Day 42]
Endpoint(s): 1. Proportion of patients with overall response of treatment success. [Time Frame: At Day 42, Day 84 and End of Study Treatment (EOST)], 2. Proportion of patients with clinical response of treatment success. [Time Frame: At Day 42, Day 84 and EOST], 3. Proportion of patients with mycological response of eradication or presumed eradication. [Time Frame: At Day 42, Day 84 and EOST], 4. Proportion of patients with radiological response of complete response or partial response. [Time Frame: At Day 42, Day 84 and EOST], 5. All-cause mortality rate at Day 84. [Time Frame: Day 84], 6. Incidence of treatment-emergent adverse events (TEAEs), serious adverse events (SAEs), treatment-related AEs, adverse events of special interest (AESI), and AEs leading to discontinuation. [Time Frame: Screening up to follow-up 6 weeks after EOST (target duration approximately up to 8 months)]], 7. Number of patients with clinically significant laboratory abnormalities. [Time Frame: Up to follow-up 6 weeks after EOST (target duration approximately up to 8 months)], 8. Number of patients with abnormal neurological examination findings [Time Frame: Up to follow-up 6 weeks after EOST (target duration approximately up to 8 months)], 9. Assessment of 12-lead electrocardiogram (ECGs). [Time Frame: Up to follow-up 6 weeks after EOST (target duration approximately up to 8 months)], 10. Plasma concentrations versus time of fosmanogepix (prodrug) and manogepix (active moiety) following IV administration. [Time Frame: Pre-dose, 3,6, and 9 hours post-start of the 3-hour IV infusion on Day 3, and at 24 hours (prior to Day 4 dosing)], 11. Plasma concentrations versus time of fosmanogepix (prodrug) and manogepix (active moiety) following oral administration. [Time Frame: On days 7, 14, 28, and 42. Post-dose plasma samples will also be collected: 72 hrs (± 1 day) and 192 hrs (± 2 days) after last dose.]

Source: https://euclinicaltrials.eu/ctis-public/view/2024-516216-16-00